EU clinical trial 2025-521632-12-00: A Phase 3 prospective randomised clinical trial of VMX-C001 vs usual pharmacological care in patients receiving a FXa direct oral anticoagulant (FXa DOAC) who require urgent surgery or other invasive procedure that is associated with a high risk of bleeding, with or without planned administration of heparin (EQUILIBRIX-S)
Protocol code: VMX-C001-06
Sponsor: VarmX B.V. (Pharmaceutical company). Phase: Therapeutic confirmatory (Phase III). Countries: Belgium (authorised, recruitment pending), Germany (authorised, recruitment pending), Italy (authorised, recruitment pending), France (authorised, recruitment pending), Czechia (authorised, recruitment pending), Bulgaria (authorised, recruitment pending), Hungary (authorised, recruitment pending), Spain (authorised, recruitment pending), Netherlands (authorised, recruitment pending), Poland (authorised, recruitment pending), Austria (authorised, recruitment pending), Estonia (authorised, recruitment pending), Romania (authorised, recruitment pending), Portugal (authorised, recruitment pending), Lithuania (authorised, recruitment pending).
Therapeutic area(s): Diseases [C] - Hemic and Lymphatic Diseases [C15]
Gender: Female, Male. Age: 18-64 years, 65+ years. Enrolment: 443.
Status: Authorised, recruitment pending. Decision date: 2026-05-19. Results received: No. Last updated: 2026-08-07.
Decision dates by country: BG: 2026-05-22, FR: 2026-05-26, HU: 2026-05-21, RO: 2026-05-25, PL: 2026-05-25, LT: 2026-05-28, AT: 2026-05-25, BE: 2026-05-19, CZ: 2026-05-20, EE: 2026-05-21, DE: 2026-05-19, IT: 2026-05-22, PT: 2026-05-22, ES: 2026-05-25, NL: 2026-05-21

Condition(s): Patients on Factor Xa inhibitor treatment needing an urgent intervention associated with a high risk of bleeding

Primary endpoint: Proportion of participants with good or excellent haemostatic efficacy during the required procedure as determined by an independent blinded EAC.

Source: https://euclinicaltrials.eu/ctis-public/view/2025-521632-12-00